EU clinical trial 2024-516331-27-00: A clinical study to learn about the safety and effects of KIN-2787, a new oral anticancer drug for the treatment of patients with BRAF and/or NRAS Mutation-positive Solid Tumors
Protocol code: KN-8701/KIN2787CI101
Sponsor: Pierre Fabre Medicament (Pharmaceutical company). Phase: Human Pharmacology (Phase I)- Other. Countries: France (ongoing, recruiting), Spain (ongoing, recruiting), Italy (ongoing, recruiting), Germany (authorised, recruitment pending).
Therapeutic area(s): Diseases [C] - Neoplasms [C04]
Gender: Female, Male. Age: 18-64 years, 65+ years. Enrolment: 182.
Start date (EU): 2022-06-10. Decision date: 2024-10-15. Results received: No. Last updated: 2026-07-17.
Decision dates by country: FR: 2024-10-18, IT: 2025-06-17, DE: 2025-12-22, ES: 2025-01-22

Condition(s): Participants with BRAF and/or NRAS mutation positive tumors

Source: https://euclinicaltrials.eu/ctis-public/view/2024-516331-27-00